EU clinical trial 2023-505330-95-01: EWALL-PH-03: An open label, 2-arm, Randomised phase II study to Compare the Safety and Efficacy of Ponatinib plus Chemotherapy with Imatinib plus Chemotherapy as front-line therapy for patients aged 55 years and over with Philadelphia chromosome positive (Ph+ or BCR-ABL+) Acute Lymphoblastic Leukemia (ALL)
Protocol code: SPON - 1751-19
Sponsor: Cardiff University (Educational Institution). Phase: Therapeutic exploratory (Phase II). Countries: Sweden (ongoing, recruiting), Finland (ongoing, recruiting), France (ongoing, recruitment ended).
Therapeutic area(s): Diseases [C] - Hemic and Lymphatic Diseases [C15]
Gender: Female, Male. Age: 18-64 years, 65+ years. Enrolment: 100.
Start date (EU): 2025-01-30. Decision date: 2025-01-30. Results received: No. Last updated: 2026-05-29.
Decision dates by country: SE: 2025-01-30, FI: 2025-01-30, FR: 2025-01-30

Condition(s): Blood cancer
Product: Imatinib TAD 400 mg επικαλυμμένα με λεπτό υμένιο δισκία, Iclusig 15 mg film-coated tablets, BLINCYTO 38.5 micrograms powder for concentrate and solution for solution for infusion.

Primary endpoint: Achievement of a molecular response in treatment arms 1 and 2 defined by a BCR-ABL1/ABL1 (B/A) transcript ratio of ≤10-4 by the time point scheduled for MRD analysis after consolidation 2 (for arms 1 and 2) or within 5 months after start of study treatment, whichever is earlier.
Endpoint(s): Event-free survival (EFS), with an event defined as failure to achieve a CR, progression, relapse or death, Confirmed undetectable BCR-ABL1 transcripts with an assay sensitivity of at least 10-4.5 at any time prior to maintenance therapy, after completing consolidation therapy, Molecular response defined by a B/A ratio ≤ 0.0003% in bone marrow, Time to best molecular response- this will be measured as time to event, Adverse event grade 3 to 5, measured at each treatment cycle, Discontinuation of study treatment due to an adverse event, Adverse events of special interest: cardiovascular and thromboembolic AE, pancreatitis, cytokine release syndrome, tumour lysis syndrome, neurologic AEs ≥ grade 3, measured at each treatment cycle, Early death: defined by death during the induction period from inclusion to complete remission or before day 56, Death in complete remission-measured as a proportion, Detection of a T315I or p-loop mutation, Detection of a compound mutation, Relapse - measured as a proportion, Premature discontinuation of ponatinib or imatinib due to toxicity, Relapse free survival - Relapse free survival (RFS) is calculated from the date of documented complete remission to date of relapse or death, whatever is earlier. Patients still in remission will be censored at the time of last follow-up, Overall survival- Overall survival (OS) is calculated from the first day of therapy to the date of death. Surviving patients will be censored at the time of last follow-up

Source: https://euclinicaltrials.eu/ctis-public/view/2023-505330-95-01